EU clinical trial 2024-520443-16-00: Efficacy and safety of NNC0487-0111 s.c. once-weekly in participants with overweight or obesity, and obstructive sleep apnoea treated with positive airway pressure (AMAZE 4)
Protocol code: NN9490-8293
Sponsor: Novo Nordisk A/S (Pharmaceutical company). Phase: Therapeutic confirmatory (Phase III). Countries: Poland (ongoing, recruiting), Spain (ongoing, recruiting), Germany (ongoing, recruiting).
Therapeutic area(s): Diseases [C] - Nutritional and Metabolic Diseases [C18]
Gender: Female, Male. Age: 18-64 years, 65+ years. Enrolment: 115.
Status: Ongoing, recruiting. Start date (EU): 2026-05-04. Decision date: 2026-03-24. Results received: No. Last updated: 2026-05-25.
Decision dates by country: DE: 2026-03-24, ES: 2026-03-27, PL: 2026-04-03

Condition(s): Overweight or obesity, and obstructive sleep apnoea treated with positive airway preassure (PAP)
Product: NNC0487-0111 B 10146, NNC0487-0111 B 10144, NNC0487-0111 B 10142, NNC0487-0111 B 10143, NNC0487-0111 B 10145, NNC0487-0111 B 10141, Placebo

Primary endpoint: Relative change in body weight, Change in apnoea-hypopnoea index (AHI)
Endpoint(s): Relative change in AHI, Achievement of 50% reduction in AHI (Yes/No), Achievement of: AHI < 5 or AHI 5-14 with Epworth Sleepiness Scale (ESS) ≤ 10 (Yes/No), Change in sleep apnoea specific hypoxic burden (SASHB), Change in ESS score, Change in Patient-Reported Outcomes Measurement Information System (PROMIS) Short Form v1.0 Sleep-Related Impairment 8a score, Change in PROMIS Short Form v1.0 Sleep Disturbance 8b score, Change in body weight, Change in body mass index (BMI), Improvement in obstructive sleep apnoea (OSA) severity category: AHI < 5/hour = normal (Yes/No) ≥ 5 and < 15/hour = mild (Yes/No) ≥ 15 and < 30/hour = moderate (Yes/No) ≥ 30/hour = severe (Yes/No), Withdrawal of positive airway pressure (PAP) therapy (Yes/No), Change in waist circumference, Change in neck circumference, Change in systolic blood pressure (SBP), Change in diastolic blood pressure (DBP), Change in high-sensitivity C-reactive protein (hsCRP), Change in lipids: Total cholesterol High-density lipoprotein (HDL) cholesterol Low-density lipoprotein (LDL) cholesterol Very low-density lipoprotein (VLDL) cholesterol Non-HDL cholesterol Triglycerides, Change in fasting plasma glucose, Change in glycated haemoglobin (HbA1c), Number of: Treatment emergent adverse events (TEAEs) Treatment emergent serious adverse events (TESAEs) TEAEs leading to permanent treatment discontinuation

Source: https://euclinicaltrials.eu/ctis-public/view/2024-520443-16-00